EU clinical trial 2024-516714-37-00: Non-commercial clinical trial of statins CAncer preventive and Pleiotropic TherApy IN smokers with chronic obstructive pulmonary disease (COPD) Clinical part: Atorvastatin effect on reduction of COPD exacerbations. Genomic part: Assessment of immunobiology of COPD related lung carcinoma and inflammatory pathways activation based on gene expression profiles of the peripheral blood leukocytes (PBLs) and peripheral blood mononuclear cells (PBMCs) from smokers with chronic obstructive pulmonary disease (COPD).
Protocol code: 2019/ABM/01/00074
Sponsor: Medical University Of Bialystok (Educational Institution). Phase: Therapeutic confirmatory (Phase III). Countries: Poland (ongoing, recruitment ended).
Therapeutic area(s): Diseases [C] - Respiratory Tract Diseases [C08]
Gender: Female, Male. Age: 18-64 years, 65+ years. Enrolment: 480.
Status: Ongoing, recruitment ended. Start date (EU): 2022-01-19. Decision date: 2024-12-02. Results received: No. Last updated: 2024-12-02.

Condition(s): Chronic obstructive pulmonary disease (COPD)
Product: Placebo, Atoris, 40 mg, tabletki powlekane

Primary endpoint: Exacerbation rate, Time to exacerbation
Endpoint(s): Duration of exacerbation, Changes in forced expiratory volume in the first second (FEV1), Changes in health-related quality of life (SGRQ score), Changes in inflammatory pathway gene expression in the PBMCs by whole transcriptome RNA-seq analysis., Changes in blood inflammatory markers (Peripheral blood leucocyte count, fibrinogen, Interleukin-6, high sensitivity C – reactive protein), Changes from baseline in pre-dose values of plethysmography (functional residual volume (FRC), inspiratory capacity (IC), transfer factor of the lung for carbon monoxide (DLCO), 6 minute walking distance (6MWD) and the rate of hospitalizations, Changes in vital signs (blood pressure, HR), and/or laboratory findings., The rate of hospitalization (pulmonary or MACE)

Source: https://euclinicaltrials.eu/ctis-public/view/2024-516714-37-00